EU clinical trial 2025-523665-24-00: A clinical trial to learn about the effects of JFI447 and how it shows up in scans compared to FFG233 in people with solid tumors
Protocol code: CJFI447A02101
Sponsor: Novartis Pharma AG (Pharmaceutical company). Phase: Human Pharmacology (Phase I)- First administration to humans. Countries: Denmark (authorised, recruitment pending).
Therapeutic area(s): Diseases [C] - Neoplasms [C04]
Gender: Female, Male. Age: 18-64 years, 65+ years. Enrolment: 22.
Status: Authorised, recruitment pending. Decision date: 2026-06-10. Results received: No. Last updated: 2026-06-10.

Condition(s): Patients with metastatic PDAC, NSCLC, HR+/HER2- ductal and lobular BC, TNBC, CRC or STS.

Source: https://euclinicaltrials.eu/ctis-public/view/2025-523665-24-00